EU clinical trial 2024-515924-35-00: Anticoagulation for New-Onset Post-Operative Atrial Fibrillation after CABG - PACeS
Protocol code: PACeS, final 3.0
Sponsor: Icahn School Of Medicine At Mount Sinai (Educational Institution). Phase: Therapeutic use (Phase IV). Countries: Germany (ongoing, recruiting).
Therapeutic area(s): Diseases [C] - Cardiovascular Diseases [C14]
Gender: Female, Male. Age: 18-64 years, 65+ years. Enrolment: 750.
Status: Ongoing, recruiting. Start date (EU): 2023-01-16. Decision date: 2024-07-29. Results received: No. Last updated: 2025-06-11.

Condition(s): New-Onset Post-Operative Atrial Fibrillation after CABG
Product: Xarelto 10 mg film-coated tablets, Lixiana 15 mg film-coated tablets, Brilique 60 mg film-coated tablets, Aspirin 500 mg überzogene Tabletten, Clopidogrel ratiopharm 75 mg film-coated tablets, Pradaxa 75 mg hard capsules, Eliquis 2.5 mg film-coated tablets, Clopidogrel ratiopharm 75 mg film-coated tablets, Brilique 60 mg film-coated tablets, Xarelto 10 mg film-coated tablets, Xarelto 10 mg film-coated tablets, Eliquis 2.5 mg film-coated tablets, Lixiana 15 mg film-coated tablets, Clopidogrel ratiopharm 75 mg film-coated tablets, Brilique 60 mg film-coated tablets, Xarelto 10 mg film-coated tablets, Xarelto 10 mg film-coated tablets, Xarelto 10 mg film-coated tablets, Pradaxa 75 mg hard capsules, Eliquis 2.5 mg film-coated tablets, Pradaxa 75 mg hard capsules, Clopidogrel ratiopharm 75 mg film-coated tablets, Clopidogrel ratiopharm 75 mg film-coated tablets, Brilique 60 mg film-coated tablets, Xarelto 10 mg film-coated tablets, Xarelto 10 mg film-coated tablets, Eliquis 2.5 mg film-coated tablets, Pradaxa 75 mg hard capsules, Clopidogrel ratiopharm 75 mg film-coated tablets, Eliquis 2.5 mg film-coated tablets, Xarelto 10 mg film-coated tablets, Pradaxa 75 mg hard capsules, Clopidogrel ratiopharm 75 mg film-coated tablets, Clopidogrel ratiopharm 75 mg film-coated tablets, Eliquis 2.5 mg film-coated tablets, Marcumar 3 mg Tabletten, Brilique 60 mg film-coated tablets, Clopidogrel ratiopharm 75 mg film-coated tablets, Xarelto 10 mg film-coated tablets

Primary endpoint: Primary effectiveness endpoint: composite of death, ischemic stroke, transient ischemic attack (TIA), myocardial infarction (MI), systemic arterial thromboembolism or venous thromboembolism (VTE) (deep venous thrombosis (DVT) and/or pulmonary embolism (PE)), Primary safety endpoint: Bleeding Academic Research Consortium (BARC) type 3 or 5
Endpoint(s): Composite of death, ischemic stroke, TIA, MI, or systemic arterial thromboembolism, Net clinical benefit (NCB), Incidence of the primary effectiveness and safety endpoints at 180 days after randomization, Individual components of the primary effectiveness and safety endpoints at 90 d and 180 days after randomization, Cardiovascular and non-cardiovascular mortality at 90 and180 days after randomization, Incidence of BARC 2 bleeding at 90 and 180 days after randomization, Cardiac arrhythmias including recurrent symptomatic or asymptomatic AF requiring medical attention at 90 and 180 days after randomization, Length of stay of index hospitalization, Number and reasons for readmissions at 90 and 180 days after rendomization, Hospital resource utilization at 180 days after surgey, Patients' convenience and satisfaction survey utilizing the Perception of Anticoagulation Treatment Questionnaire (PACT-Q2) at 90 days after randomization

Source: https://euclinicaltrials.eu/ctis-public/view/2024-515924-35-00